EU clinical trial 2024-514080-25-00: A Phase 3 Study of Relacorilant in Combination with Nab-Paclitaxel versus Nab-Paclitaxel Monotherapy in Advanced, Platinum-Resistant, High-Grade Epithelial Ovarian, Primary Peritoneal, or Fallopian-Tube Cancer (ROSELLA)
Protocol code: CORT125134-556
Sponsor: Corcept Therapeutics Inc. (Pharmaceutical company). Phase: Therapeutic confirmatory (Phase III). Countries: Belgium (ongoing, recruitment ended), Italy (ongoing, recruitment ended), France (ongoing, recruitment ended), Hungary (ended), Poland (ended), Spain (ongoing, recruitment ended).
Therapeutic area(s): Diseases [C] - Neoplasms [C04]
Gender: Female. Age: 18-64 years, 65+ years. Enrolment: 205.
Start date (EU): 2023-04-21. Decision date: 2024-07-31. Results received: No. Last updated: 2026-07-17.
Decision dates by country: PL: 2024-08-07, HU: 2024-08-01, FR: 2024-08-05, BE: 2024-08-05, ES: 2024-07-31, IT: 2024-09-17

Condition(s): Advanced, Platinum-Resistant, High-Grade Epithelial Ovarian, Primary Peritoneal, or Fallopian-Tube Cancer
Product: CORT125134, Abraxane 5 mg/ml powder for dispersion for infusion., relacorilant

Primary endpoint: The dual primary efficacy endpoints include the following: • PFS: Time from randomization until first documented progressive disease (PD) by RECIST v1.1 per BICR, or death due to any cause, whichever occurs first, • ▪ OS: Time from randomization to death by any cause.
Endpoint(s): • PFS (Investigators): Time from randomization until PD or death whichever occurred first as assessed by Investigator using RECIST v1.1., • ORR: Proportion of patients with measurable disease at Baseline who attain complete response (CR) or partial response (PR) by RECIST v1.1. • BoR: Recorded from the date of randomization until PD/recurrence (or death). • DoR: Time from the first objective response (CR or PR) to first objectively documented PD or death (whichever occurs first)., • CBR at 24 weeks: proportion of patients who attain CR, PR, or stable disease (SD) for 24 weeks as per RECIST v1.1. • CA-125 response will be assessed per GCIG criteria • Combined response according to RECIST v1.1 + GCIG criteria. Responses will be reported separately and combined for RECIST v1.1 and CA-125/GCIG criteria.

Source: https://euclinicaltrials.eu/ctis-public/view/2024-514080-25-00